EU clinical trial 2025-520513-30-00: Concentration guided dose reduction versus standard dosing in tocilizumab treated heumatoid arthritis patients:a randomised, international, multicenter, non-inferiority trial
Sponsor: Reade revalidatie & reumatologie centrum te Amsterdam (Hospital/Clinic/Other health care facility). Phase: Therapeutic use (Phase IV). Countries: Netherlands (authorised, recruitment pending).
Therapeutic area(s): Diseases [C] - Immune System Diseases [C20]
Gender: Female, Male. Age: 18-64 years, 65+ years. Enrolment: 98.
Status: Authorised, recruitment pending. Decision date: 2025-01-16. Results received: No. Last updated: 2025-01-16.

Condition(s): Rheumatoid arthritis
Product: TOCILIZUMAB

Primary endpoint: The primary objective of this study is to investigate the difference in mean time weighted DAS28 after 28 weeks between concentration-guided dose reduction and standard dosing. This analysis will be based on the non-inferiority principle, since we expect no worse outcome for patients in whom the dosing interval will be adjusted compared to patients who continue on the regular tocilizumab dose. As explained in the sample size calculation, the mean time weighted DAS28 is expected to be 2.8, with a
Endpoint(s): We will look at the difference in mean time weighted DAS28 after 52 weeks between the two treatment groups., The difference in CDAI, SDAI, and HAQ score after 28 weeks and 52 weeks between the two treatment groups, The direct medical costs of TDM compared to the standard treatment regimen, The difference in number of flares between the two treatment arms at 28 and 52 weeks, The number and severity of adverse events in both treatment arms, The difference in drug levels in the intervention group between week 0 and 52, The change in drug levels from baseline after 52 weeks of intervention, The relationship between dose, drug concentration, and clinical disease activity, The therapeutic range of tocilizumab, The development of a pharmacokinetic model resulting in a dashboard system, The perspective of the patients about optimizing their dose with therapeutic drug monitoring

Source: https://euclinicaltrials.eu/ctis-public/view/2025-520513-30-00